EU clinical trial 2025-523067-38-01: Phase 1/1b Study of BMS-986463 in Advanced Malignant Tumors
Protocol code: CA231-0000
Sponsor: Bristol-Myers Squibb Services Unlimited Company (Pharmaceutical company). Phase: Human Pharmacology (Phase I)- First administration to humans. Countries: Spain (authorised, recruitment pending), France (authorised, recruitment pending), Italy (authorised, recruitment pending).
Therapeutic area(s): Diseases [C] - Neoplasms [C04]
Gender: Female, Male. Age: 18-64 years, 65+ years. Enrolment: 20.
Status: Authorised, recruitment pending. Decision date: 2026-07-21. Results received: No. Last updated: 2026-07-27.
Decision dates by country: FR: 2026-07-21, ES: 2026-07-27, IT: 2026-07-23

Condition(s): Advanced Malignant Tumors; High-grade Serous Ovarian Carcinoma (HGSOC), Uterine Serous Carcinoma (USC), Non-small Cell Lung Cancer (NSCLC)

Source: https://euclinicaltrials.eu/ctis-public/view/2025-523067-38-01